EU clinical trial 2022-502311-12-00: "neoBREASTIM": A Phase 2 Study of Atezolizumab plus RP1 oncolytic immunotherapy in the NeoAdjuvant setting of Triple-Negative Breast Cancer (TNBC)
Protocol code: IC 2021-10
Sponsor: Institut Curie (Laboratory/Research/Testing facility). Phase: Therapeutic exploratory (Phase II). Countries: France (ended).
Therapeutic area(s): Diseases [C] - Neoplasms [C04]
Gender: Female. Age: 18-64 years, 65+ years. Enrolment: 51.
Status: Ended. Start date (EU): 2024-04-05. End date (EU): 2025-05-07. Decision date: 2023-08-18. Results received: Yes. Last updated: 2025-01-17.

Condition(s): Patients with early-stage Triple Negative Breast Cancer
Product: Tecentriq 840 mg concentrate for solution for infusion, Vusolimogene oderparepvec

Primary endpoint: Safety run-in: The incidence, nature and severity of adverse events, with severity graded according to NCI CTCAE v5.0, Phase II: Residual cancer burden RCB 0-1 rate at time of surgery in patients with no increase in ctDNA after cycle 3.
Endpoint(s): The safety and toxicity of the combination therapy will be estimated from the treatment start to the surgery, in terms of duration and severity based on CTCAE v5.0, among all evaluable patients with less than 3 cycles, The rate of RCB 0-1 will be estimated with its 95% exact confidence interval; among patients with no increase in ctDNA after cycle 3, The safety and toxicity of the combination therapy will be estimated from the treatment start to the surgery, in terms of duration and severity based on CTCAE v5.0, among patients with no increase in ctDNA after cycle 3, Invasive disease-free survival (iDFS) in all evaluable subjects will be estimated using the Kaplan-Meier method. iDFS is defined as the time from the date of inclusion to the date of loco-regional relapse, distant relapse, or death, whatever happens first; for patients without such events, the date of last contact will be used, among patients with no increase in ctDNA after cycle 3, The percentage of TILs will be estimated and compared between RCB rates 0-1 versus 2-3; TILs will be assessed according to the International TILs Working Group 2014 2 and the RCB 0-1 rate according to Symmans et al.1; Among patients with no increase in ctDNA after cycle 3, The pre-treatment expression of PD-L1 (continuous variable and dichotomous variable) will be estimated and compared between RCB rates 0-1 versus 2-3; PD-L1 expression will be assessed using the PD-L1 IHC SP142 assay with the IC scoring system, among patients with no increase in ctDNA after cycle 3, Association between RCB rates and response by PET-CT or breast MRI will be studied, among patients with no increase in ctDNA after cycle 3, To correlate the response by breast MRI with RCB 0-1 rates, among patients with no increase in ctDNA after cycle 3, The rate of Breast Conservation Surgery (BCS) will be presented, among patients with no increase in ctDNA after cycle 3, Association between RCB rates and response by radiomics analyses, among patients with no increase in ctDNA after cycle 3, For the patients with increase in ctDNA after cycle 3 and treated by standard therapeutic approach (3 patients expected), the rate of patients with increased ctDNA and a descriptive analysis of this population will be performed.

Source: https://euclinicaltrials.eu/ctis-public/view/2022-502311-12-00